EU clinical trial 2024-519882-23-00: A study to learn how the study medicine called [14C]PF-07054894 is processed by the body.
Protocol code: C4151008
Sponsor: Pfizer Inc. (Pharmaceutical company). Phase: Human Pharmacology (Phase I)- Other. Countries: Netherlands (ended).
Therapeutic area(s): Diseases [C] - Immune System Diseases [C20]
Gender: Male. Age: 18-64 years, 65+ years. Enrolment: 10.
Status: Ended. Start date (EU): 2025-06-13. End date (EU): 2025-09-11. End date: 2025-09-12. Decision date: 2025-05-15. Results received: No. Last updated: 2025-05-15.

Condition(s): Inflammatory bowel disease.

Source: https://euclinicaltrials.eu/ctis-public/view/2024-519882-23-00